EU clinical trial 2024-515069-33-00: A phase IIIb, open-label, single arm study to evaluate the efficacy and safety of luspatercept in patients with lower-risk MDS and ringsideroblastic phenotype (MDS-RS)
Protocol code: LUSPLUS
Sponsor: GWT-Tud GmbH (Pharmaceutical company). Phase: Therapeutic confirmatory (Phase III). Countries: Spain (ongoing, recruitment ended), Austria (ended), Germany (ended).
Therapeutic area(s): Diseases [C] - Hemic and Lymphatic Diseases [C15]
Gender: Female, Male. Age: 18-64 years, 65+ years. Enrolment: 48.
Start date (EU): 2022-02-15. Decision date: 2024-10-29. Results received: No. Last updated: 2026-03-17.
Decision dates by country: AT: 2024-11-05, DE: 2024-10-30, ES: 2024-10-29

Condition(s): Patients with anemia due to IPSS-R defined very low-, low-, or intermediate-risk MDS-RS who require RBC transfusions and who are refractory, intolerant or ineligible to prior erythropoiesis-stimulating agents (ESA) treatment
Product: Reblozyl 75 mg powder for solution for injection, Reblozyl 25 mg powder for solution for injection

Primary endpoint: RBC-TI rate according to IWG 2018 modified criteria[1] from Week 1 through Week 24
Endpoint(s): RBC-TI rate according to IWG 2006 criteria from Week 1 through Week 24 and through Week 52, Median time to RBC-TI (Week 1 through Week 24 and through Week 52), Median duration of RBC-TI (Week 1 through Week 24 and through Week 52), Change in RBC units transfused over a fixed 16-weeks period (Week 9 through Week 24 and Week 37 through Week 52) compared to the 16-week period prior to screening, Proportion of subjects achieving mean Hb increase ≥ 1.0 g/dL over ≥ 8 weeks (Week 1 through Week 24 and through Week 52), Proportion of subjects achieving modified hematologic improvement - erythroids (mHI-E) per IWG 2006 criteria (Week 1 through Week 24 and through Week 52), Proportion of subjects achieving hematologic improvement - neutrophils (HI-N) per IWG 2006 criteria (Week 1 through Week 24 and through Week 52), Proportion of subjects achieving hematologic improvement - platelets (HI-P) per IWG 2006 criteria (Week 1 through Week 24 and through Week 52), Mean change in serum ferritin from Week 9 through 24 and Week 37 through Week 52 compared to baseline, Mean change in mean daily dose of ICT from Week 9 through 24 and Week 37 through Week 52 compared to baseline, Proportion of subjects with progression to AML, Overall survival (OS), Safety measures: type, frequency, severity of adverse events (AEs) and relationship to luspatercept, dose reductions and dose delays, Mean change in PRO (via EORTC QLQ-C30) and PerfO (via “Timed Up and Go test” [TUG]) from baseline (Week 1) to Week 52 and to End of Treatment (EOT)

Source: https://euclinicaltrials.eu/ctis-public/view/2024-515069-33-00